EU clinical trial 2024-516610-38-00: Assessment of the impairment of the serotoninergic system during the prodromal phase of Parkinson’s disease in SNCA mutation carriers by PET using [11C]DASB and [11C]SB207145 : SerIAL-PD
Protocol code: C24-41
Sponsor: Institut National De La Sante Et De La Recherche Medicale (Laboratory/Research/Testing facility). Phase: Phase II and Phase III (Integrated). Countries: France (authorised, recruitment pending).
Therapeutic area(s): Diseases [C] - Nervous System Diseases [C10]; Diseases [C] - Pathological Conditions, Signs and Symptoms [C23]; Analytical, Diagnostic and Therapeutic Techniques and Equipment [E] - Diagnosis [E01]
Gender: Female, Male. Age: 18-64 years, 65+ years. Enrolment: 50.
Status: Authorised, recruitment pending. Decision date: 2025-08-29. Results received: No. Last updated: 2026-02-10.

Condition(s): Parkinson's disease, Prodromal phase of Parkinson's disease
Product: 11C-SB207145, 11C-DASB

Primary endpoint: Determine PET-binding potential of radiotracer ligands [11C]DASB and [11C]SB207145 to respective serotonin transporter SERT and receptor 5-HT4, and compare between SNCA+ PD- participants and SNCA- PD- participants.
Endpoint(s): Determine PET-binding potential of radiotracer ligands [11C]DASB and [11C] SB207145, and compare results between all groups., Determine correlations between PET-binding potential of radiotracer ligands [11C]DASB and [11C] SB207145 and scores on motor and non-motor symptom assessment scales, and compare results between all groups., Determine correlations between PET-binding potential of radiotracer ligands [11C]DASB and [11C] SB207145, DaTSCAN results, and neuromelanin-sensitive MRI (NM-MRI)) results, and compare results between all groups., Determine correlations between PET-binding potential of radiotracer ligands [11C]DASB and [11C] SB207145, DaTSCAN results, neuromelanin-sensitive MRI (NM-MRI) results, scores on motor and non-motor symptom assessment scales, and measurements of blood and cerebrospinal biomarkers, and compare results between all groups., Determine the difference between anatomical and functional MRI images between groups and correlations with clinical scores and PET data.

Source: https://euclinicaltrials.eu/ctis-public/view/2024-516610-38-00